EU clinical trial 2023-509466-38-00: B9991046 - AVELUMAB MASTER PROTOCOL: AN OPEN-LABEL CONTINUATION STUDY FOR PARTICIPANTS CONTINUING FROM PFIZER-SPONSORED AVELUMAB CLINICAL STUDIES
Protocol code: B9991046
Sponsor: Pfizer Inc. (Pharmaceutical company). Phase: Therapeutic confirmatory (Phase III). Countries: Belgium (ended), France (ended), Hungary (ended), Italy (ongoing, recruitment ended), Denmark (ended), Spain (ongoing, recruitment ended), Poland (ongoing, recruitment ended).
Therapeutic area(s): Diseases [C] - Neoplasms [C04]
Gender: Female, Male. Age: 18-64 years. Enrolment: 14.
Start date (EU): 2022-03-08. Decision date: 2024-08-07. Results received: No. Last updated: 2026-06-11.
Decision dates by country: DK: 2024-08-13, HU: 2024-08-12, FR: 2024-09-03, PL: 2024-08-09, IT: 2024-09-16, BE: 2024-08-08, ES: 2024-08-07

Condition(s): Cancer
Product: AVELUMAB, LORLATINIB, AXITINIB, AXITINIB, TALAZOPARIB, TALAZOPARIB

Primary endpoint: AEs leading to permanent discontinuation of study intervention, All SAEs

Source: https://euclinicaltrials.eu/ctis-public/view/2023-509466-38-00